EU clinical trial 2024-519688-16-00: A Multicenter, Randomized, Open-Label, Blinded Endpoint Evaluation, Active-Controlled Study to Compare the Efficacy and Safety of SRSD107 and Enoxaparin in Adult Subjects Undergoing Elective Primary Unilateral Total Knee Arthroplasty.
Protocol code: SRSD107-201
Sponsor: Sirius Therapeutics Inc. (Pharmaceutical company). Phase: Therapeutic exploratory (Phase II). Countries: Latvia (ongoing, recruiting), Bulgaria (ongoing, recruiting), Hungary (ongoing, recruiting), Czechia (ongoing, recruiting), Poland (ongoing, recruiting), Lithuania (ongoing, recruiting).
Therapeutic area(s): Diseases [C] - Cardiovascular Diseases [C14]
Gender: Female, Male. Age: 18-64 years, 65+ years. Enrolment: 278.
Status: Ongoing, recruiting. Start date (EU): 2025-08-07. Decision date: 2025-07-01. Results received: No. Last updated: 2026-07-17.
Decision dates by country: LT: 2025-07-03, PL: 2025-07-07, HU: 2025-07-02, CZ: 2025-07-03, LV: 2025-07-01, BG: 2025-07-07

Condition(s): venous thromboembolism
Product: SRSD107 Injection, Clexane 4.000 I. E. (40 mg)/0,4 ml Injektionslösung in einer Fertigspritze, 0.9% sodium chloride solution for injection

Primary endpoint: Incidence of total venous thromboembolism (VTE) events, defined as deep vein thrombosis (DVT) (asymptomatic confirmed by venography assessment of the operated leg or objectively confirmed symptomatic), non-fatal and fatal PE, and unexplained death for which PE cannot be excluded, from the date of surgery through the venography visit. Venography will be performed 12±2 days after surgery
Endpoint(s): Incidence of composite of major bleeding (MB) and clinically relevant non-major bleeding (CRNMB) from the Pre-surgical Period through the venography visit, Incidence of composite of MB, CRNMB, and any bleeding (including minor bleeding events) from the Pre-surgical Period through the venography visit, Day 64, and Day 169, respectively, Incidence of MB from the Pre-surgical Period through the venography visit, Incidence of CRNMB from the Pre-surgical Period through the venography visit, Incidence of adverse events (AEs) and other safety parameters throughout the study, Incidence of major VTE, defined as objectively confirmed symptomatic DVT and PE, asymptomatic proximal DVT, fatal PE, and unexplained death for which PE cannot be excluded, from the date of surgery through the venography visit and Day 64, respectively, Incidence of total VTE events, defined as symptomatic DVT, asymptomatic DVT , non-fatal and fatal PE, and unexplained death for which PE cannot be excluded, from the date of surgery through Day 64, Incidence of total VTE events for each individual dosing cohort of SRSD107 compared to enoxaparin from the date of surgery through the venography visit

Source: https://euclinicaltrials.eu/ctis-public/view/2024-519688-16-00